EU clinical trial 2024-519414-31-00: A Phase I, Randomised, Investigator- and Participant-blinded, Placebo-Controlled, Study to Assess the Safety, Tolerability, and Pharmacodynamics of AZD4144 in Participants with Obesity.
Protocol code: D9441C00004
Sponsor: AstraZeneca AB (Pharmaceutical company). Phase: Human Pharmacology (Phase I)- Other. Countries: Germany (ended).
Therapeutic area(s): Diseases [C] - Cardiovascular Diseases [C14]
Gender: Female, Male. Age: 18-64 years. Enrolment: 28.
Status: Ended. Start date (EU): 2025-03-28. End date (EU): 2025-09-29. Decision date: 2025-03-26. Results received: No. Last updated: 2025-07-10.

Condition(s): Cardiorenal disease

Source: https://euclinicaltrials.eu/ctis-public/view/2024-519414-31-00